EU clinical trial 2023-509598-22-01: zAvatar test-guided therapeutic decision vs standard of care, in relapsed ovarian cancer and in metastatic breast cancer - A multicentric randomized clinical study with intervention
Protocol code: FC2024-001
Sponsor: Rita Fior, Champalimaud Clinical Centre, Rita Fior (Health care, Hospital/Clinic/Other health care facility, Pharmaceutical company). Phase: Therapeutic use (Phase IV). Countries: Portugal (ongoing, recruiting).
Therapeutic area(s): Diseases [C] - Neoplasms [C04]
Gender: Female. Age: 18-64 years, 65+ years. Enrolment: 276.
Status: Ongoing, recruiting. Start date (EU): 2025-05-13. Decision date: 2024-11-05. Results received: No. Last updated: 2026-02-06.

Condition(s): Oncology - Breast cancer, Oncology - Ovarian cancer
Product: GEMCITABINE HYDROCHLORIDE, CAPECITABINE, ALPELISIB, ABEMACICLIB, EVEROLIMUS, ATEZOLIZUMAB, ABEMACICLIB, TOPOTECAN, RIBOCICLIB, ALPELISIB, EPIRUBICIN HYDROCHLORIDE, GEMCITABINE HYDROCHLORIDE, CYCLOPHOSPHAMIDE, PACLITAXEL, OLAPARIB, PACLITAXEL, VINORELBINE, FULVESTRANT, DOXORUBICIN HYDROCHLORIDE, OLAPARIB, MIRVETUXIMAB SORAVTANSINE, EPIRUBICIN HYDROCHLORIDE, PALBOCICLIB, CARBOPLATIN, ABEMACICLIB, CAPECITABINE, ATEZOLIZUMAB, EVEROLIMUS, CYCLOPHOSPHAMIDE, PEMBROLIZUMAB, ALPELISIB, GEMCITABINE HYDROCHLORIDE, GEMCITABINE HYDROCHLORIDE, DOXORUBICIN HYDROCHLORIDE, LIPOSOMAL, TRASTUZUMAB DERUXTECAN, DOCETAXEL, BEVACIZUMAB, TOPOTECAN, VINORELBINE, CARBOPLATIN, EVEROLIMUS, GEMCITABINE HYDROCHLORIDE, ERIBULIN MESYLATE, VINORELBINE, CYCLOPHOSPHAMIDE, EXEMESTANE, TOPOTECAN, DOCETAXEL, FULVESTRANT, DOXORUBICIN HYDROCHLORIDE, TALAZOPARIB, PALBOCICLIB, ETOPOSIDE, DOCETAXEL, TALAZOPARIB, EPIRUBICIN HYDROCHLORIDE, TALAZOPARIB, TOPOTECAN, EPIRUBICIN HYDROCHLORIDE, PALBOCICLIB, SACITUZUMAB GOVITECAN, EVEROLIMUS

Primary endpoint: PFS of patients with relapsed ovarian cancer treated according to zAvatar-test-based therapeutic decision and those treated according to clinical-choice (standard of care)., PFS of metastatic breast cancer patients treated according to zAvatar-test-based therapeutic decision and those treated according to clinical-choice (standard of care).
Endpoint(s): Response rate (RR) and overall survival (OS) of relapsed ovarian cancer patients treated according to zAvatar-based therapeutic decision and those treated according to clinical-choice (standard of care)., RR and OS of metastatic breast cancer patients treated according to zAvatar-based therapeutic decision and those treated according to clinical-choice (standard of care)., Describe HCS utilization between both treatment arms for both disease – relapsed ovarian cancer and metastatic breast cancer., Sequence selected multi-resistant/multi-sensitive responders/non-responders tumors, at the transcriptomic (single-cell) level (scRNAseq)

Source: https://euclinicaltrials.eu/ctis-public/view/2023-509598-22-01